EU clinical trial 2024-514186-18-00: A Study of GSK4527363 in Healthy Participants, Systemic Lupus Erythematosus (SLE) Participants, Healthy Chinese and Japanese Participants, and Participants with Interstitial Lung Disease Associated with Connective Tissue Disease (CTD-ILD)
Protocol code: 221458
Sponsor: Glaxosmithkline Research & Development Limited (Pharmaceutical company). Phase: Human Pharmacology (Phase I)- First administration to humans. Countries: Spain (ongoing, recruitment ended), Poland (ongoing, recruitment ended).
Therapeutic area(s): Diseases [C] - Immune System Diseases [C20]
Gender: Female, Male. Age: 18-64 years, 65+ years. Enrolment: 15.
Status: Ongoing, recruitment ended. Start date (EU): 2025-09-09. Decision date: 2025-07-18. Results received: No. Last updated: 2026-03-16.
Decision dates by country: PL: 2025-07-18, ES: 2025-07-18

Condition(s): Systemic Lupus Erythematosus

Source: https://euclinicaltrials.eu/ctis-public/view/2024-514186-18-00